EU clinical trial 2024-520204-26-00: Effects of 10 vs. 20 mL Local Anesthetic for Popliteal Plexus Block on Opioid Consumption, Pain, and Patient-Reported Outcomes after Total Knee Arthroplasty - a randomized, controlled, blinded study
Sponsor: Region Midtjylland (Hospital/Clinic/Other health care facility). Phase: Therapeutic use (Phase IV). Countries: Denmark (ended).
Therapeutic area(s): Analytical, Diagnostic and Therapeutic Techniques and Equipment [E] - Anesthesia and Analgesia [E03]
Gender: Female, Male. Age: 18-64 years, 65+ years. Enrolment: 120.
Status: Ended. Start date (EU): 2025-03-30. End date (EU): 2025-11-26. Decision date: 2025-03-17. Results received: Yes. Last updated: 2025-03-17.

Condition(s): Postoperative pain after Total Knee Arthroplasty
Product: BUPIVACAINE

Primary endpoint: Total opioid consumption from end-of-surgery time (T0) until 24 hours postoperatively (T24), expressed in oral morphine milligram equivalents (MME).
Endpoint(s): Frequency of patients with no opioid consumption from T0 until T24., Pain in the operated knee at rest, scored by NRS, obtained at the timepoints: Preoperative, at 6 hours (+/- 1 hour) after end-of-surgery time (T6), and at T24., Pain in the operated knee during a 10-meter walk with crutches, scored by NRS, obtained at the time points: Preoperative, T6 and at T24., Frequency of patients unable to walk 10 meters with crutches at T6., Frequency of Manual Muscle Test results < Grade 3 in evaluations of dorsiflexion and plantarflexion of the ankle and knee extension, examined at T6., Patient reported outcome measure of Quality of Recovery 15 at T24.

Source: https://euclinicaltrials.eu/ctis-public/view/2024-520204-26-00